EU clinical trial 2024-517280-23-00: Evaluation of pain after intra-articular botulinum toxin injections in carpometacarpal osteoarthritis of the thumb
Sponsor: Centre Hospitalier Universitaire De Nice (Hospital/Clinic/Other health care facility). Phase: Therapeutic exploratory (Phase II). Countries: France (ended).
Therapeutic area(s): Diseases [C] - Musculoskeletal Diseases [C05]
Gender: Female, Male. Age: 18-64 years, 65+ years. Enrolment: 60.
Status: Ended. Start date (EU): 2021-04-01. End date (EU): 2025-05-14. Decision date: 2024-10-18. Results received: No. Last updated: 2024-10-18.

Condition(s): Osteoarthritis of the first carpometacarpal joint
Product: Product Name : NT 201; Dosage Form : Powder for Solution for lnjection; Strength : Placebo 100 Unit (25) USP ges. Packaging : lnjection Vial; Manufacturing site(s) : Merz Pharma GmbH & Co. KGaA, Werk Dessau, Am Pharmapark, D-06861 Dessau/ Roßlau; Testing site(s) : Merz Pharma GmbH & Co. KGaA, Werk Dessau, Am Pharmapark, D-06861 Dessau/ Roßlau, XEOMIN 50 unités, poudre pour solution injectable

Primary endpoint: Evolution of the initial pain by Visual Analogue Scale compared to that measured at 3 months after the injection. Score from 0 to 10. 0 corresponds to the absence of pain and 10 to the maximum imaginable pain.

Source: https://euclinicaltrials.eu/ctis-public/view/2024-517280-23-00